EU clinical trial 2025-522633-57-00: A Phase I, Open-label, Randomized, Active-Controlled, to Evaluate the Safety and Immunogenicity of the DuoChol Oral Cholera Vaccine in 18 to 45 years old Healthy Participants in Sweden.
Sponsor: International Vaccine Institute (Laboratory/Research/Testing facility). Phase: Human Pharmacology (Phase I)- First administration to humans. Countries: Sweden (authorised, recruitment pending).
Therapeutic area(s): Diseases [C] - Bacterial Infections and Mycoses [C01]
Gender: Female, Male. Age: 18-64 years. Enrolment: 60.
Status: Authorised, recruitment pending. Decision date: 2025-10-06. Results received: No. Last updated: 2025-10-06.

Condition(s): Prevention of Cholera disease

Source: https://euclinicaltrials.eu/ctis-public/view/2025-522633-57-00